EU clinical trial 2024-517220-19-00: CELLVICROHN study: Is there a concordance between the Cellvizio with an intravenous injection of fluorescein and the pathology to determine the microscopic inflammation at the ileal resection margins in Crohn’s ileal disease.
Protocol code: PI2022_843_0111
Sponsor: Centre Hospitalier Universitaire Amiens Picardie (Hospital/Clinic/Other health care facility). Phase: Therapeutic confirmatory (Phase III). Countries: France (ongoing, recruiting).
Therapeutic area(s): Phenomena and Processes [G] - Digestive System and Oral Physiological Phenomena [G10]
Gender: Female, Male. Age: 18-64 years, 65+ years. Enrolment: 60.
Status: Ongoing, recruiting. Start date (EU): 2023-10-31. Decision date: 2024-08-22. Results received: No. Last updated: 2026-01-14.

Condition(s): Crohn's ileal disease
Product: FLUOCYNE 10%, solution injectable I.V.

Primary endpoint: is the microscopically healthy or inflammatory character of the ileal mucosal section margin for Cellvizio and pathology.
Endpoint(s): The concordance between the Cellvizio with an intravenous injection of fluorescein and the pathology for the inflammation of the serosa (transmural inflammation) and of the mesentery and the length of ileum (in cm) between the surgical margin and the theorical resection site to be in a non-inflammatory area at the Cellvizio (on the mucosa and on the serosa)..

Source: https://euclinicaltrials.eu/ctis-public/view/2024-517220-19-00